EU clinical trial 2024-511968-81-00: A Proof-of-Concept Study to Explore the Potential Efficacy of Deferiprone in Patients With Pelizaeus-Merzbacher disease (PMD)
Protocol code: 74668
Sponsor: Amsterdam UMC Stichting (Hospital/Clinic/Other health care facility). Phase: Therapeutic exploratory (Phase II). Countries: Netherlands (ongoing, recruiting).
Therapeutic area(s): Diseases [C] - Nervous System Diseases [C10]
Gender: Male. Age: 0-17 years. Enrolment: 10.
Status: Ongoing, recruiting. Start date (EU): 2024-12-27. Decision date: 2024-12-27. Results received: No. Last updated: 2026-05-11.

Condition(s): Pelizaeus-Merzbacher disease
Product: Ferriprox 100 mg/ml oral solution

Primary endpoint: Motor function as measured by the gross motor function measurement tool (GMFM-88). (Paulson and Vargus-Adams, 2017) and using the GMF scoring for metachromatic leukodystrophy, MLD-GMF score (Kehrer et al., 2011)
Endpoint(s): Quantitative brain MRI parameters: Diffusion Tensor Imaging (DTI); Chemical Shift Imaging (CSI); Neurite Orientation Dispersion and Density Imaging (NODDI); Density Imaging (NODDI); Myelin Water Fraction Imaging (MWFI), Electrophysiological parameters: EEG, Clinical parameters: General health and quality of life: Health Utility Index (HUI); Hand function: Manual Ability Classification System (MACS); Manual Ability Classification System (MACS); Communication Function Classification System (CFCS); Swallowing function: Eating and Drinking Ability Classification System (EDACS); Euro-Quality of Life Instrument 5D, 5 levels (EQ-5D-Y, proxy); Vineland Adaptive Behavior Scales, 3rd edition (Vineland-3)

Source: https://euclinicaltrials.eu/ctis-public/view/2024-511968-81-00